EU clinical trial 2023-510525-15-00: A randomized, controlled study to evaluate LNP023 (iptacopan) in patients with active ANCA-associated vasculitis.
Protocol code: CLNP023R12201
Sponsor: Novartis Pharma AG (Pharmaceutical company). Phase: Therapeutic exploratory (Phase II). Countries: Hungary (ongoing, recruitment ended), Denmark (ongoing, recruitment ended), Austria (ongoing, recruitment ended), Netherlands (ended), Spain (ongoing, recruitment ended), Germany (ongoing, recruitment ended), France (ongoing, recruitment ended), Belgium (ongoing, recruitment ended), Czechia (ongoing, recruitment ended).
Therapeutic area(s): Diseases [C] - Immune System Diseases [C20]
Gender: Female, Male. Age: 18-64 years, 65+ years. Enrolment: 44.
Start date (EU): 2024-11-18. Decision date: 2024-09-17. Results received: No. Last updated: 2026-02-02.
Decision dates by country: CZ: 2024-09-17, HU: 2024-09-30, NL: 2024-09-23, DE: 2024-09-17, BE: 2024-09-17, DK: 2024-09-17, FR: 2024-09-20, ES: 2024-09-17, AT: 2024-09-29

Condition(s): active antineutrophilic cytoplasmic antibody (ANCA) associated vasculitis
Product: IPTACOPAN, Placebo 0 mg hard gelatin capsule size 0, (placebo to LNP023)

Primary endpoint: Sustained remission through Week 48 defined as complete remission at Week 24 without major relapse up to Week 48.
Endpoint(s): Time to reach BVAS = 0, Time to major relapse through Week 48, Estimated glomerular filtration rate (eGFR) using the CKD-EI formula, urinary protein excretion and hematuria over 48 weeks.

Source: https://euclinicaltrials.eu/ctis-public/view/2023-510525-15-00